EU clinical trial 2024-511618-19-00: Effect of SAR445611 on inflammatory responses following LPS challenge study in healthy participants
Protocol code: PDY17892
Sponsor: Sanofi-Aventis Recherche & Developpement (Pharmaceutical company). Phase: Human Pharmacology (Phase I)- Other. Countries: Netherlands (ended).
Therapeutic area(s): Diseases [C] - Immune System Diseases [C20]
Gender: Male. Age: 18-64 years. Enrolment: 40.
Status: Ended. Start date (EU): 2024-06-24. End date (EU): 2024-10-07. Decision date: 2024-06-12. Results received: No. Last updated: 2024-06-12.

Condition(s): Immune system diseases

Source: https://euclinicaltrials.eu/ctis-public/view/2024-511618-19-00